EU clinical trial 2023-503244-14-00: APTIVATE Clinical Trial to Evaluate the Safety, Tolerability, Pharmacokinetics and Pharmacodynamics of Tuspetinib (HM43239) in Patients with Relapsed or Refractory Acute Myeloid Leukemia.
Protocol code: HM-FLTI-101
Sponsor: Aptose Biosciences Inc. (Pharmaceutical company). Phase: Phase I and Phase II (Integrated)- First administration to humans. Countries: Poland (ended), Germany (ended), Sweden (ended), Spain (ended).
Therapeutic area(s): Diseases [C] - Hemic and Lymphatic Diseases [C15]
Gender: Female, Male. Age: 18-64 years, 65+ years. Enrolment: 103.
Status: Ended. Start date (EU): 2023-08-11. End date (EU): 2024-09-19. Decision date: 2023-06-12. Results received: No. Last updated: 2024-08-28.
Decision dates by country: ES: 2023-06-16, SE: 2023-06-12, PL: 2023-06-19, DE: 2023-06-14

Condition(s): Relapsed or Refractory Acute Myeloid Leukemia (AML)

Source: https://euclinicaltrials.eu/ctis-public/view/2023-503244-14-00